EU clinical trial 2023-509048-80-01: Randomized, double-blind, phase 2 clinical trial controlled with conventional Bacillus Calmette-Guérin (BCG) vaccine to evaluate the safety and immunogenicity of a recombinant BCG vaccine that expresses the respiratory syncytial virus (RSV) nucleoprotein (N) (rBCG-N-RSV) in adults over 60 years of age.
Protocol code: rBCG-N-RSV 002GR
Sponsor: Biothervax SpA (Laboratory/Research/Testing facility). Phase: Therapeutic exploratory (Phase II). Countries: Greece (authorised, recruitment pending).
Therapeutic area(s): Diseases [C] - Virus Diseases [C02]
Gender: Female, Male. Age: 18-64 years, 65+ years. Enrolment: 200.
Status: Authorised, recruitment pending. Decision date: 2024-11-21. Results received: No. Last updated: 2026-03-31.

Condition(s): The present Phase 2 clinical study will evaluate the safety and immunogenicity of the immunogenic formulation cGMP rBCG-N-RSV of 100,000 CFU in adults over 60 years of age.
Product: TUBERCULOSIS, LIVE ATTENUATED, rBCG-N-RSV vaccine

Primary endpoint: Occurrence, intensity, and duration of the local solicited AEs (evolution of the "flare-up") until the generation of the scar., Occurrence, intensity and duration of unsolicited AEs during the 6-month follow-up., Occurrence of AEs during the 6-month follow-up duration., Alterations to the hemogram and/or biochemical profile at 30- and 180- days post vaccination compared to pre-vaccination profile., Production of IFN-γ and IL-2 by T cells upon exposure to purified protein derivative (PPD) mycobacterial antigen 7 days prior vaccination and 30- and 180-days post vaccination., Production of IFN-γ and IL-2 by T cells upon exposure to recombinant RSV nucleoprotein antigen 7 days prior vaccination and 30- and 180-days post vaccination.
Endpoint(s): Presence and titers of serum IgG antibodies against Purified Protein Derived Mycobacterial antigen (PPD) via ELISA., Presence and titers of serum IgG against RSV nucleoprotein via ELISA.

Source: https://euclinicaltrials.eu/ctis-public/view/2023-509048-80-01